EU clinical trial 2024-518286-95-00: A Phase I, randomized, consecutive dose, double blind, parallel study comparing the PK, PD, immunogenicity, safety and tolerability of LB-0702 and Nplate® in healthy volunteers.
Protocol code: RJ-ROM02
Sponsor: Laboratorio Reig Jofre S.A. (Pharmaceutical company). Phase: Human Pharmacology (Phase I)- Bioequivalence Study. Countries: Spain (ongoing, recruiting), Portugal (authorised, recruitment pending).
Therapeutic area(s): Not possible to specify
Gender: Male. Age: 18-64 years. Enrolment: 146.
Start date (EU): 2025-07-02. Decision date: 2025-03-18. Results received: No. Last updated: 2026-08-05.
Decision dates by country: ES: 2025-03-18, PT: 2026-08-05

Condition(s): Not applicable (submitted trial is a bioequivalence study)

Source: https://euclinicaltrials.eu/ctis-public/view/2024-518286-95-00